EU clinical trial 2024-515061-33-00: The effect of sertraline on anxiety-depressive symptoms, endothelial dysfunction and biomarkers in heart failure patients with preserved ejection fraction
Protocol code: NBK531/1/2022
Sponsor: Medical University Of Gdansk (Educational Institution). Phase: Therapeutic confirmatory (Phase III). Countries: Poland (ended).
Therapeutic area(s): Diseases [C] - Cardiovascular Diseases [C14]; Psychiatry and Psychology [F] - Mental Disorders [F03]
Gender: Female, Male. Age: 18-64 years, 65+ years. Enrolment: 485.
Status: Ended. Start date (EU): 2024-03-22. End date (EU): 2025-12-05. Decision date: 2024-12-09. Results received: No. Last updated: 2025-07-24.

Condition(s): Depressive-anxiety states in people with heart failure with preserved ejection fraction
Product: Asentra, 50 mg, tabletki powlekane, PL1

Primary endpoint: Time to hospitalization for cardiovascular reasons or death from any cause
Endpoint(s): a. time to hospitalization for any cause, b. time to death for any cause, c. time to hospitalization for cardiovascular causes, d. time to death for cardiovascular causes, e. total time to death or hospitalization for any cause f. Change in the PHQ-9 and GAD-7 scale score from the last measurement before drug administration g. SF-12 scale score mental h.g. SF-12 mental score h. 8a. KCCQ-12 score 8b. NYHA class 8c. CCS class i. Level of biomarkers related to endothelial function

Source: https://euclinicaltrials.eu/ctis-public/view/2024-515061-33-00